EU clinical trial 2022-502691-23-00: Combined treatment of intraperitoneal chemotherapy after optimal interval surgery in advanced ovarian cancer
Protocol code: IMIB-BICOV-2022-01
Sponsor: Fundacion Para La Formacion E Investigacion Sanitaria De La Region De Murcia (Educational Institution). Phase: Therapeutic use (Phase IV). Countries: Spain (ongoing, recruiting).
Therapeutic area(s): Diseases [C] - Female Urogenital Diseases and Pregnancy Complications [C13]
Gender: Female. Age: 18-64 years, 65+ years. Enrolment: 20.
Status: Ongoing, recruiting. Start date (EU): 2023-02-27. Decision date: 2023-06-21. Results received: No. Last updated: 2023-06-27.
Decision dates by country: ES: 2023-06-27

Condition(s): Ovarian cancer
Product: Paclitaxel Hospira 6 mg/ml concentrado para solución para perfusión EFG, Cisplatino Pharmacia 1 mg/ml concentrado para solución para perfusión EFG

Primary endpoint: The safety variable of the study will be postoperative Morbidity and Mortality. Morbidity will be defined based on the NCI‐CTCAE v4 scale classification., The variables related to the treatment effectiveness will be disease free and overall survival.
Endpoint(s): The secondary variable will be the patients' life quality once treatment finished, evaluated using the EORTC QLQ-C30 and EORTC QLQ-CR29 questionnaires.

Source: https://euclinicaltrials.eu/ctis-public/view/2022-502691-23-00